EU clinical trial 2024-510776-20-00: POLAR: A phase III open-label, multicenter, randomized trial of adjuvant palbociclib in combination with endocrine therapy versus endocrine therapy alone for patients with hormone receptor positive / HER2-negative resected isolated locoregional recurrence of breast cancer
Protocol code: IBCSG 59-19
Sponsor: ETOP IBCSG Partners Foundation (Laboratory/Research/Testing facility). Phase: Therapeutic confirmatory (Phase III). Countries: France (ongoing, recruitment ended), Italy (ongoing, recruitment ended), Spain (ongoing, recruitment ended), Austria (ongoing, recruitment ended), Hungary (ongoing, recruitment ended).
Therapeutic area(s): Diseases [C] - Neoplasms [C04]
Gender: Female, Male. Age: 18-64 years, 65+ years. Enrolment: 381.
Status: Ongoing, recruitment ended. Start date (EU): 2019-10-25. Decision date: 2024-04-04. Results received: No. Last updated: 2026-07-17.
Decision dates by country: HU: 2024-04-04, AT: 2024-04-08, IT: 2024-04-04, FR: 2024-04-04, ES: 2024-04-08

Condition(s): Female or male patients with histologically confirmed HR-positive, HER2-negative resected isolated locoregional recurrence (ILRR) of breast cancer.
Product: IBRANCE 125 mg film-coated tablets, IBRANCE 100 mg film-coated tablets, IBRANCE 75 mg hard capsules, IBRANCE 75 mg film-coated tablets, IBRANCE 100 mg hard capsules, IBRANCE 125 mg hard capsules

Primary endpoint: The primary endpoint iDFS is defined as duration of time from randomization until first appearance of invasive local, regional, or distant recurrence (including invasive ipsilateral breast tumor recurrence), invasive contralateral breast cancer, a second (non-breast) invasive cancer, or death from any cause.
Endpoint(s): The secondary endpoints are: - Adverse events, according to CTCAE version 5 - Breast cancer-free interval (BCFI) - Distant recurrence-free interval (DRFI) - Overall survival (OS)

Source: https://euclinicaltrials.eu/ctis-public/view/2024-510776-20-00